EU clinical trial 2025-525157-39-00: A Prospective, Randomized, Controlled, Multinational, Phase 2/3, Open-Label Trial to Evaluate the Efficacy and Safety of SIL204-SL Administered as an Integrated Therapeutic Regimen in Combination with Chemotherapy vs. Chemotherapy Treatment Alone in Participants with Locally Advanced Pancreatic Cancer
Protocol code: SIL204SL-P001
Sponsor: Silexion Therapeutics Ltd. (Pharmaceutical company). Phase: Phase II and Phase III (Integrated). Countries: Germany (authorised, recruitment pending).
Therapeutic area(s): Diseases [C] - Neoplasms [C04]
Gender: Female, Male. Age: 18-64 years, 65+ years. Enrolment: 10.
Status: Authorised, recruitment pending. Decision date: 2026-06-23. Results received: No. Last updated: 2026-06-23.

Condition(s): Non-Resectable Locally Advanced Pancreatic Cancer (LAPC)
Product: SIL204-SL

Primary endpoint: Primary trial endpoint: Overall survival (OS) is defined as the time from date of randomization to the date of death from any cause. OS will be assessed for up to 24 months following randomization. OS analysis will compare participants from Segments 2 & 3 who were randomized to receive the SIL204-SC dose selected for Segment 3 + SIL204-IT +SoC chemotherapy, with participants from Segments 2 & 3 who received SoC chemotherapy and who harbor KRAS G12D or KRAS G12V mutations., Endpoints Segment 1: • AEs graded according to National Cancer Institute Common Terminology Criteria for Adverse Event (NCI CTCAE v.6.0). • Dose limiting toxicity (DLT), which could prevent SIL204- SL from being administered at a higher dose., Endpoints Segments 2 and 3: • Incidence, severity and causality of AEs graded according to National Cancer Institute Common Terminology Criteria for Adverse Events (NCI CTCAE; v.6.0). • OS, Progression free survival (PFS), complete response (CR), partial response (PR) or stable disease (SD), and Participant reported Outcomes (PROs).
Endpoint(s): Difference between treatment arms in ORR, defined as proportion of participants achieving complete (CR) and partial response (PR) by CT using RECIST v1.1 criteria., Difference between treatment arms in DCR, defined as proportion of participants achieving CR, PR and stable disease (SD) by CT using RECIST v1.1 criteria., Comparison of PFS, defined as time from randomization to documented disease progression by CT using RECIST v1.1 criteria or death from any cause, whichever occurs first., Difference between treatment arms in change from baseline in HRQoL scores as measured by the EORTC QLQ-C30 and its pancreatic cancer-specific module EORTC QLQ-PAN26, in participant reported pain assessed by visual analogue scale, and in generic health status as measured by the EQ-5D-5L.

Source: https://euclinicaltrials.eu/ctis-public/view/2025-525157-39-00